EU clinical trial 2025-523390-42-00: A Phase 2, Multicenter, Randomized, Double-blind, Placebocontrolled Study, to Evaluate Efficacy, Safety, Tolerability, and Pharmacodynamics of Intrathecally Administered Mivelsiran in Adult Participants with Early-Stage Down Syndrome-Associated Alzheimer’s Disease (DS-AD)
Protocol code: ALN-APP-003
Sponsor: Alnylam Pharmaceuticals Inc. (Pharmaceutical company). Phase: Therapeutic exploratory (Phase II). Countries: Italy (authorised, recruitment pending), Netherlands (authorised, recruitment pending), Spain (authorised, recruitment pending), Germany (authorised, recruitment pending), Ireland (authorised, recruitment pending).
Therapeutic area(s): Diseases [C] - Nervous System Diseases [C10]
Gender: Female, Male. Age: 18-64 years. Enrolment: 17.
Status: Authorised, recruitment pending. Decision date: 2026-07-22. Results received: No. Last updated: 2026-07-24.
Decision dates by country: DE: 2026-07-22, IE: 2026-07-24, ES: 2026-07-23, NL: 2026-07-23, IT: 2026-07-23

Condition(s): Early-Stage Down Syndrome-Associated Alzheimer’s Disease (DS-AD)
Product: Mivelsiran, Isotonic aqueous buffer suitable for IT injection

Primary endpoint: Change from baseline to Month 24 in amyloid PET as measured in CLs
Endpoint(s): Change from baseline to Month 24 in sAPPβ concentration in CSF, Change from baseline to Month 24 in sAPPα concentration in CSF, Change from baseline to Month 24 in concentration of Aβ42 in CSF, Change from baseline to Month 24 in concentration of p-tau217 in plasma, Change from baseline to Month 24 on mCRT

Source: https://euclinicaltrials.eu/ctis-public/view/2025-523390-42-00